EU clinical trial 2025-524646-94-00: Optimizing Aspirin Use for Preeclampsia Prevention
Protocol code: Optim-PRE26
Sponsor: Fundacio Hospital Universitari Vall D’Hebron Institut De Recerca (Laboratory/Research/Testing facility). Phase: Phase III and phase IV (Integrated). Countries: Spain (authorised, recruitment pending).
Therapeutic area(s): Not possible to specify
Gender: Female. Age: 18-64 years. Enrolment: 11836.
Status: Authorised, recruitment pending. Decision date: 2026-05-07. Results received: No. Last updated: 2026-07-05.

Condition(s): Obstetrics – Preeclampsia
Product: ACETYLSALICYLIC ACID

Primary endpoint: To assess whether ASA discontinuation at 24–26 weeks is non-inferior in preventing preterm PE compared with the control group, who will continue ASA until 36 weeks.
Endpoint(s): To assess whether ASA discontinuation does not increase maternal, fetal, or neonatal morbidity or mortality., To assess whether ASA discontinuation discontinuing aspirin treatment reduces the risk of maternal hemorrhage, Carry out a comprehensive clinical and economic analysis to assess the cost-effectiveness of the screening program and the incremental value of incorporating specific markers (PlGF, UtA-PI, and ophthalmic artery Doppler) in different socioeconomic contexts., Determine optimized risk thresholds specific to each population and performance metrics that facilitate the translation into evidence based policies and resource allocation in both European and African healthcare systems., Compare different methods for determining the placental growth factor (PlGF): point-of-care devices versus ELISA/ECLIA., To evaluate the role of the ophthalmic artery in the prediction of preeclampsia (PE)., Develop models using clinical data, ultrasound markers, and biomarkers to predict cases that will develop preeclampsia despite adequate treatment with ASA.

Source: https://euclinicaltrials.eu/ctis-public/view/2025-524646-94-00